EU clinical trial 2025-524176-36-00: A study to learn about how a new nurandociguat tablet is absorbed and processed in the body compared to an old tablet and how food affects the way the new tablet is absorbed and processed in the body
Protocol code: 22700
Sponsor: Bayer AG (Pharmaceutical company). Phase: Human Pharmacology (Phase I)- Other. Countries: Germany (authorised, recruitment pending).
Therapeutic area(s): Diseases [C] - Cardiovascular Diseases [C14]
Gender: Female, Male. Age: 18-64 years. Enrolment: 18.
Status: Authorised, recruitment pending. Decision date: 2026-03-25. Results received: No. Last updated: 2026-03-25.

Condition(s): Chronic Kidney Disease

Source: https://euclinicaltrials.eu/ctis-public/view/2025-524176-36-00